EU clinical trial 2023-503700-81-00: Palliation of Dyspnea and Cough using Morphine in patients with Fibrotic Interstitial Lung Disease
Protocol code: Morpheus
Sponsor: Aarhus University Hospital (Hospital/Clinic/Other health care facility). Phase: Therapeutic use (Phase IV). Countries: Denmark (ongoing, recruiting).
Therapeutic area(s): Diseases [C] - Respiratory Tract Diseases [C08]
Gender: Female, Male. Age: 18-64 years, 65+ years. Enrolment: 110.
Status: Ongoing, recruiting. Start date (EU): 2024-08-23. Decision date: 2024-03-11. Results received: No. Last updated: 2024-10-24.

Condition(s): Fibrotic Interstitial Lung Disease
Product: Malfin, depottabletter, Contalgin, depottabletter, Contalgin, depottabletter, MST CONTINUS 5 mg prolonged-release tablets, PLACEBO

Primary endpoint: The change in average VAS score for dyspnea the last 24-hours (baseline) measured over a week and after 4 weeks treatment with morphine.
Endpoint(s): Change in walking distance during 6-minute walk test from baseline to follow-up after 4 weeks of treatment, Change in level of desaturation at 6-minute walk test from baseline to follow-up after 4 weeks of treatment, Change in BORG dyspnea scale at 6-minute walk test from baseline to follow-up after 4 weeks of treatment, Change in questionnaire (VAS for tough, Leicester Cough Questionnaire, King's Brief Lung Disease Questionnaire, COPD assessment Score) from baseline to follow-up after 4 weeks of treatment

Source: https://euclinicaltrials.eu/ctis-public/view/2023-503700-81-00